EU clinical trial 2024-514517-35-00: IMPACT-AML: A RANDOMIZED PRAGMATIC CLINICAL TRIAL FOR RELAPSE OR REFRACTORY ACUTE MYELOID LEUKEMIA
Protocol code: IRST204.07
Sponsor: Istituto Romagnolo Per Lo Studio Dei Tumori Dino Amadori IRST S.r.l. (Hospital/Clinic/Other health care facility). Phase: Therapeutic confirmatory (Phase III). Countries: Germany (ongoing, recruiting), Czechia (authorised, recruiting), Italy (ongoing, recruiting), Lithuania (ongoing, recruiting), Spain (ongoing, recruiting), Portugal (authorised, recruiting), Romania (ongoing, recruiting).
Therapeutic area(s): Diseases [C] - Neoplasms [C04]
Gender: Female, Male. Age: 18-64 years, 65+ years. Enrolment: 267.
Start date (EU): 2025-02-27. Decision date: 2024-11-27. Results received: No. Last updated: 2026-05-08.
Decision dates by country: PT: 2025-05-12, RO: 2025-06-23, DE: 2024-11-27, LT: 2024-11-28, IT: 2024-11-27, ES: 2024-12-02, CZ: 2024-11-28

Condition(s): Acute myeloid leukemia
Product: GLASDEGIB, DAUNORUBICIN, AZACITIDINE, AMSACRINE, CYTARABINE, DECITABINE, FLUDARABINE, ETOPOSIDE, GILTERITINIB, IDARUBICIN, VENETOCLAX, MITOXANTRONE, IVOSIDENIB, CYTARABINE, CLADRIBINE, GEMTUZUMAB OZOGAMICIN

Primary endpoint: Event-free survival is defined as time from randomization to treatment failure, hematologic relapse from CR/CRh/Cri or death from any cause, whichever occurs first
Endpoint(s): Overall survival, defined as time from randomization to the date of death from any cause, Overall response rate (CR/CRh/CRi, MLFS) as the best assessment of response during the study treatment and the overall study cohort, Change in Hematologic Malignancy–Patient-Reported Outcome (HM-PRO) A-total as defined by the HM-PRO questionnaire between screening and end of treatment assessment., Proportion of patients experiencing adverse events

Source: https://euclinicaltrials.eu/ctis-public/view/2024-514517-35-00